EU clinical trial 2024-515377-10-00: Faricimab for high-frequent Aflibercept treated Neovascular age-related macular degeneration: a monocenter, randomized, double-masked comparator-controlled study (FAN study)
Sponsor: Medical University Of Graz (Educational Institution). Phase: Phase III and phase IV (Integrated). Countries: Austria (ended).
Therapeutic area(s): Diseases [C] - Eye Diseases [C11]
Gender: Female, Male. Age: 18-64 years, 65+ years. Enrolment: 70.
Status: Ended. Start date (EU): 2023-06-12. End date (EU): 2025-02-26. Decision date: 2024-11-18. Results received: Yes. Last updated: 2024-11-18.

Condition(s): Neovascular age-related macular degeneration
Product: Vabysmo 120 mg/mL solution for injection, Eylea 40 mg/mL solution for injection in pre-filled syringe

Primary endpoint: proportion of eyes with at least one extension without retinal (intra- and subretinal) fluid within the time period baseline to 32 weeks (extension success rate)
Endpoint(s): proportion of eyes with maximum extended interval without retinal (intra- and subretinal) fluid of ≥ 6, ≥ 8 and ≥ 10 weeks at 32 weeks, maximum extended treatment interval without retinal (intra- and subretinal) fluid at 32 weeks, number of injections received during 32 weeks, proportion of eyes with maximum extended interval without retinal (intra-and subretinal) fluid of ≥ 6, ≥ 8, ≥ 10 and ≥12weeks at 56 weeks, proportion of eyes remaining on a 4-weekly interval from baseline to last visit (completed interval) at 56 weeks, maximum extended treatment interval without retinal (intra- and subretinal) fluid at 56 weeks, number of injections received during 1 year, mean change in EDTRS letter score from baseline to an averaged EDTRS letter score between 24 and 32 weeks, mean averaged EDTRS letter score between 24 and 32 weeks, mean change in EDTRS letter score from baseline to an averaged EDTRS letter score between 48 and 56 weeks, mean averaged EDTRS letter score between 48 and 56 weeks, proportion of eyes gaining ≥ 5 EDTRS letters from baseline to an averaged EDTRS letter score between 24 and 32 weeks, proportion of eyes loosing ≥5 EDTRS letters from baseline to an averaged EDTRS letter score between 24 and 32 weeks, proportion of eyes gaining ≥ 5 EDTRS letters from baseline to an averaged EDTRS letter score between 48 and 56 weeks, proportion of eyes loosing ≥5 EDTRS letters from baseline to an averaged EDTRS letter score between 48 and 56 weeks, mean change in low-luminance BCVA from baseline over time, mean CST change from baseline (1mm EDTRS grid) to an averaged CST between 24 and 32 weeks, mean CST change from baseline (1mm EDTRS grid) to an averaged CST between 48 and 56 weeks, proportion of eyes with no intraretinal fluid at baseline, last visit (completed interval) at or before 32 weeks and at or before 56 weeks, proportion of eyes with no subretinal fluid at baseline, last visit (completed interval) at or before 32 weeks and at or before 56 weeks, proportion of eyes with no retinal (intra- and subretinal) fluid at baseline, last visit (completed interval) at or before 32 weeks and at or before 56 weeks, retinal nerve fiber analysis over time, incidence and severity of ocular/non-ocular adverse events, initial concentration of plasma VEGF-A, Ang-2, mean change in concentration of plasma VEGF-A, Ang-2 over time, change in NEI VFO-25 total score over time

Source: https://euclinicaltrials.eu/ctis-public/view/2024-515377-10-00